EU clinical trial 2024-515646-16-00: Pembrolizumab in combination with lenvatinib in patients with recurrent, persistent, metastatic or locally advanced vulvar cancer not amenable to curative surgery or radiotherapy
Protocol code: AGO-VULVA-1
Sponsor: AGO Research GmbH (Pharmaceutical company). Phase: Therapeutic exploratory (Phase II). Countries: Germany (ongoing, recruiting).
Therapeutic area(s): Diseases [C] - Neoplasms [C04]
Gender: Female. Age: 18-64 years, 65+ years. Enrolment: 42.
Status: Ongoing, recruiting. Start date (EU): 2025-06-24. Decision date: 2025-02-03. Results received: No. Last updated: 2026-07-17.

Condition(s): Recurrent, persistent, metastatic or locally advanced vulvar cancer
Product: Lenvatinib, Lenvatinib, KEYTRUDA 25 mg/mL concentrate for solution for infusion

Primary endpoint: Efficacy of lenvatinib + pembrolizumab in terms of objective response rate (ORR). ORR will be defined as the proportion of patients with PR or CR within 24 weeks starting with the first study treatment. Tumor responses will be assessed by the investigator per Response Evaluation Criteria in Solid Tumors (RECIST 1.1)
Endpoint(s): ORR for whole trial duration. DCR=proportion of pts with PR/CR/SD for 8 weeks. DOR=time from response until 1st PD or death, whichever occurs first. OS=time from therapy start to death. PFS=time from therapy start to PD or death, whichever occurs first. TFST=time from therapy start until start of 1st subsequent therapy or death whichever occurs first. TSST=time from therapy start until start of 2nd subsequent therapy or death whichever occurs first. Tumor response assessed by INV per RECIST 1.1., Quality of life is measured by patient reported outcome instruments EORTC QLQ-C30 and QLQ-VU34., Events according to common terminology criteria for adverse events (CTCAE Version 5.0), dose reductions, delays or interruptions.

Source: https://euclinicaltrials.eu/ctis-public/view/2024-515646-16-00